EU clinical trial 2024-513964-24-00: A Phase III randomized trial of avelumab-cetuximab- Radiotherapy versus standards of care in locally advanced squamous cell carcinoma of the head and neck (REACH)
Protocol code: GORTEC 2017-01
Sponsor: Groupe Oncologie Radiotherapie Tete Cou (Patient organisation/association). Phase: Therapeutic confirmatory (Phase III). Countries: France (ongoing, recruitment ended).
Therapeutic area(s): Diseases [C] - Neoplasms [C04]
Gender: Female, Male. Age: 18-64 years, 65+ years. Enrolment: 706.
Status: Ongoing, recruitment ended. Start date (EU): 2017-09-14. Decision date: 2024-09-04. Results received: No. Last updated: 2026-01-16.

Condition(s): Squamous cell carcinoma, previously untreated Stage III, stage IVa (operable, but not operated) or IVb (non resectable) Oral cavity, oropharynx, hypopharynx or larynx
Product: Erbitux 5 mg/mL solution for infusion, Bavencio 20 mg/mL concentrate for solution for infusion, Erbitux 5 mg/mL solution for infusion, Cisplatin Accord Healthcare 1 mg/ml solution à diluer pour perfusion

Primary endpoint: PFS defined as the time between randomization and the first event among progression (per radiologico-pathological combined Head & Neck cancer assessment using Response Evaluation Criteria in Solid Tumors (RECIST) version (v)1.1 (see Appendix) and death, whatever the cause of death
Endpoint(s): Overall survival, Cumulative incidence of locoregional failure, cumulative incidence of distant metastatic failure by Investigator assessment (Appendix 3) and cumulative incidence of death without previous progression, Safety: Acute adverse events and laboratory abnormalities as graded by National Cancer Institute (NCI) Common Terminology Criteria for Adverse Events (CTCAE), v4.03. Incidence of delayed toxicity (e.g.; dysphagia, chronic swallowing dysfunctions, speech problems, cervical fibrosis, rate and duration of the use of feeding tubes);, Patient-Reported Outcomes: Health related quality of life (QL) assessed by EORTC QLQC30 and H&N35 questionnaires, Progression Free Survival 2 (PFS2) defined as the time from randomization to progression on subsequent treatment for logoregional relapse, distant metastasis or detah from any cause

Source: https://euclinicaltrials.eu/ctis-public/view/2024-513964-24-00